EU clinical trial 2023-509115-84-00: Open-label, Phase 2 study of tusamitamab ravtansine (SAR408701) combined with pembrolizumab and tusamitamab ravtansine (SAR408701) combined with pembrolizumab and platinum-based chemotherapy with or without pemetrexed in patients with CEACAM5-positive expression advanced/metastatic nonsquamous non-small-cell lung cancer (NSQ NSCLC)
Protocol code: ACT16146
Sponsor: Sanofi-Aventis Recherche & Developpement (Pharmaceutical company). Phase: Therapeutic exploratory (Phase II). Countries: France (ended).
Therapeutic area(s): Diseases [C] - Neoplasms [C04]
Gender: Female, Male. Age: 18-64 years, 65+ years. Enrolment: 3.
Status: Ended. Start date (EU): 2021-05-12. End date (EU): 2024-12-24. End date: 2024-12-25. Decision date: 2024-10-15. Results received: Yes. Last updated: 2024-12-18.

Condition(s): Cancer
Product: PEMETREXED, Tusamitamab ravtansine, CISPLATIN, CARBOPLATIN, KEYTRUDA 25 mg/mL concentrate for solution for infusion

Primary endpoint: Incidence of study drug-related dose-limiting toxicity (DLTs) at Cycle 1 (C1D1 to C1D21), Expansion part (including participants treated at the recommended dose for expansion [RDE] from the Safety Run-in part): Objective response rate (ORR)
Endpoint(s): Incidence of treatment-emergent adverse events (TEAEs), serious adverse events (SAEs), and laboratory abnormalities according to Common Terminology Criteria for Adverse Events (CTCAE) V5.0, Progression-free survival (PFS), Disease control rate (DCR), Duration of response (DOR), ORR, Pharmacokinetic concentrations, Incidence of anti-therapeutic antibodies (ATAs) against tusamitamab ravtansine

Source: https://euclinicaltrials.eu/ctis-public/view/2023-509115-84-00